EU clinical trial 2023-510296-56-00: A Phase 3 Study of Erdafitinib Compared with Vinflunine or Docetaxel or Pembrolizumab in Subjects with Advanced Urothelial Cancer and Selected FGFR Gene Aberrations
Protocol code: 42756493BLC3001
Sponsor: Janssen Cilag International (Pharmaceutical company). Phase: Therapeutic confirmatory (Phase III). Countries: France (ended), Spain (ended), Belgium (ended).
Therapeutic area(s): Diseases [C] - Neoplasms [C04]
Gender: Female, Male. Age: 18-64 years, 65+ years. Enrolment: 179.
Status: Ended. Start date (EU): 2018-03-26. End date (EU): 2026-02-11. Decision date: 2024-04-08. Results received: No. Last updated: 2025-08-26.
Decision dates by country: FR: 2024-04-22, ES: 2024-04-08, BE: 2024-05-16

Condition(s): Advanced Urothelial Cancer
Product: KEYTRUDA 25 mg/mL concentrate for solution for infusion, Javlor 25 mg/mL concentrate for solution for infusion, JNJ-42756493, JNJ-42756493, JNJ-42756493, Docetaxel-ratiopharm 20mg/ml Konzentrat zur Herstellung einer Infusionslösung

Primary endpoint: The primary endpoint is overall survival (OS). Overall survival is measured from the date of randomization to the date of the subject's death. If the subject is alive or the vital status is unknown, the subject will be censored at the date the subject was last known to be alive

Source: https://euclinicaltrials.eu/ctis-public/view/2023-510296-56-00